EU clinical trial 2025-520613-31-00: A Phase 3, Randomized, Double-Blind, Placebo-Controlled, Parallel Group Study to Evaluate the Safety and Efficacy of KarXT + KarX-EC for the Treatment of Agitation Associated with Alzheimer’s Disease (ADAGIO-1)
Protocol code: CN012-0023
Sponsor: Bristol-Myers Squibb Services Unlimited Company (Pharmaceutical company). Phase: Therapeutic confirmatory (Phase III). Countries: Portugal (ongoing, recruiting), Croatia (ongoing, recruiting), Bulgaria (ongoing, recruiting), Greece (ongoing, recruiting), Spain (ongoing, recruiting), Romania (ongoing, recruiting).
Therapeutic area(s): Psychiatry and Psychology [F] - Mental Disorders [F03]
Gender: Female, Male. Age: 18-64 years, 65+ years. Enrolment: 103.
Status: Ongoing, recruiting. Start date (EU): 2025-10-31. Decision date: 2025-10-20. Results received: No. Last updated: 2026-06-24.
Decision dates by country: RO: 2025-10-22, BG: 2025-10-21, PT: 2025-11-14, GR: 2025-10-20, ES: 2025-10-22, HR: 2025-10-22

Condition(s): Agitation Associated with Alzheimer’s Disease
Product: KarX-EC, KarX-EC, KarXT, KarXT matching Placebo, KarX-EC matching Placebo, KarXT, KarX-EC, KarXT, KarX-EC, KarXT

Primary endpoint: Change from baseline to the end of treatment on the CMAI-IPA total score compared with placebo.
Endpoint(s): Change from baseline to the end of treatment on the CGI-S as it relates specifically to agitation compared with placebo.

Source: https://euclinicaltrials.eu/ctis-public/view/2025-520613-31-00